EU clinical trial 2024-515841-41-00: An open label, randomized, crossover, two-period, two-sequence, multiple dose study to assess the relative bioavailability of Rotigotine 4.5 mg (2 mg/24 hrs) transdermal patch (Test Product) compared to Neupro® 2 mg/24 h Transdermal Patch (Reference product) in 48 healthy adult volunteers under fasting conditions.
Protocol code: 988/24
Sponsor: Eva Pharma For Pharmaceuticals And Medical Appliances SAE (Pharmaceutical company). Phase: Human Pharmacology (Phase I)- Bioequivalence Study. Countries: Czechia (ended).
Therapeutic area(s): Diseases [C] - Nervous System Diseases [C10]
Gender: Female, Male. Age: 18-64 years. Enrolment: 48.
Status: Ended. Start date (EU): 2024-11-04. End date (EU): 2024-12-06. Decision date: 2024-09-13. Results received: No. Last updated: 2024-10-04.

Condition(s): Not applicable (submitted trial is a bioavailability study in healthy subjects).

Source: https://euclinicaltrials.eu/ctis-public/view/2024-515841-41-00